EU clinical trial 2024-517996-19-00: A multicentre, randomized, double-blind, placebo-controlled, parallel-group study to evaluate the efficacy and safety of BP1.4979 in adult patients with primary premature ejaculation
Protocol code: P24-04
Sponsor: Bioprojet Pharma (Pharmaceutical company). Phase: Therapeutic exploratory (Phase II). Countries: France (ongoing, recruiting).
Therapeutic area(s): Phenomena and Processes [G] - Reproductive and Urinary Physiological Phenomena [G08]
Gender: Male. Age: 18-64 years. Enrolment: 75.
Status: Ongoing, recruiting. Start date (EU): 2025-06-19. Decision date: 2025-06-02. Results received: No. Last updated: 2026-06-22.

Condition(s): Primary premature ejaculation
Product: Matches test product

Primary endpoint: The primary efficacy endpoint is the mean change on the IELT mean post-baseline values (IELTf) collected from the randomization visit to the end of treatment visit compared to the IELT mean of pre-baseline values (IELTb) collected prior to the randomization visit.
Endpoint(s): Change in the ejaculatory control per sexual encounter measured by a 4-point Likert scale from Visit 1 to Visit 4 in BP1.4979-treated versus placebo-treated patients, Change in the overall ejaculatory control measured by a 5-point Likert scale from Visit 1 to Visit 4 in BP1.4979-treated versus placebo-treated patients, Change in the Male Sexual Health Questionnaire (MSHQ) sub-score erection scale from Visit 1 to Visit 4 in BP1.4979-treated versus placebo-treated patients, Change in the Male Sexual Health Questionnaire (MSHQ) sub-score ejaculation scale from Visit 1 to Visit 4 in BP1.4979-treated versus placebo-treated patients, Change in the Male Sexual Health Questionnaire (MSHQ) sub-score ejaculation dysfunction bother item from Visit 1 to Visit 4 in BP1.4979-treated versus placebo-treated patients, Change in the Male Sexual Health Questionnaire (MSHQ) sub-score ejaculation satisfaction scale from Visit 1 to Visit 4 in BP1.4979-treated versus placebo-treated patients, Change in the Male Sexual Health Questionnaire (MSHQ) sexual activity and desire scale items from Visit 1 to Visit 4 in BP1.4979-treated versus placebo-treated patients, Patient Global Impression Scale - Improvement (PGI-I) at visit 4 only, Change in the Male Sexual Health Questionnaire (MSHQ) sub-score erection dysfunction bother item from Visit 1 to Visit 4 in BP1.4979-treated versus placebo-treated patients

Source: https://euclinicaltrials.eu/ctis-public/view/2024-517996-19-00